EU clinical trial 2025-522440-41-00: A Phase 2, Dose Ranging, Randomized, Double-blind, Placebo-controlled Study to Evaluate the Efficacy and Safety of BFB759 in Patients with Moderate to Severe Hidradenitis Suppurativa (COMPASS 2 - HS)
Protocol code: CL-BFB759-003
Sponsor: Bluefin Biomedicine Inc. (Pharmaceutical company). Phase: Therapeutic exploratory (Phase II). Countries: Spain (ongoing, recruiting), Germany (ongoing, recruiting), Czechia (ongoing, recruiting), Poland (ongoing, recruiting), Bulgaria (ongoing, recruiting).
Therapeutic area(s): Diseases [C] - Skin and Connective Tissue Diseases [C17]; Diseases [C] - Immune System Diseases [C20]
Gender: Female, Male. Age: 18-64 years, 65+ years. Enrolment: 123.
Status: Ongoing, recruiting. Start date (EU): 2026-04-27. Decision date: 2026-03-31. Results received: No. Last updated: 2026-04-10.
Decision dates by country: BG: 2026-04-01, CZ: 2026-04-02, DE: 2026-04-07, PL: 2026-04-03, ES: 2026-03-31

Condition(s): Hidradenitis Suppurativa
Product: Placebo, BFB759

Primary endpoint: Percent change from Baseline (Week 0) at Week 16 in count of AN for Active 1 and Active 2 groups versus Placebo group
Endpoint(s): Analysis (Active 1 and Active 2 compared to Placebo): Proportion of participants meeting criteria for HiSCR50 defined as at least a 50% decrease in AN count with no increase in the number of abscesses and no increase in the number of dTs at Week 16 relative to Baseline (Week 0) and over time relative to Baseline (Week 0)., Proportion of participants meeting criteria for HiSCR75 defined as at least a 75% decrease in AN count with no increase in the number of abscesses and no increase in the number of dTs at Week 16 relative to Baseline (Week 0) and over time relative to Baseline (Week 0)., Proportion of participants meeting criteria for HiSCR90 defined as at least a 90% decrease in AN count with no increase in the number of abscesses and no increase in the number of dTs at Week 16 relative to Baseline (Week 0) and over time relative to Baseline (Week 0)., Percent change from Baseline (Week 0) at Week 16 on the IHS4, Percent change from Baseline (Week 0) at Week 16 on the skin pain NRS, Proportion of participants meeting criteria for IHS4-55 defined as at least a 55% reduction in IHS4 score at Week 16 relative to Baseline (Week 0), Proportion of participants meeting criteria for IHS4-90 defined as at least a 90% reduction in IHS4 score at Week 16 relative to Baseline (Week 0)., Safety and tolerability will be assessed by the incidence and severity of TEAEs (described by CTCAE Version 5.0)

Source: https://euclinicaltrials.eu/ctis-public/view/2025-522440-41-00